EU clinical trial 2023-507753-15-00: Study with healthy volunteers to investigate the safety, tolerability, blood concentration and some effects of various amounts of the pharmaceutical substance SR-878
Protocol code: SR-878-01-001
Sponsor: SciRhom GmbH (Laboratory/Research/Testing facility). Phase: Human Pharmacology (Phase I)- Other. Countries: Austria (ended).
Therapeutic area(s): Not possible to specify
Gender: Female, Male. Age: 18-64 years. Enrolment: 52.
Status: Ended. Start date (EU): 2024-10-08. End date (EU): 2025-05-14. Decision date: 2024-03-11. Results received: No. Last updated: 2024-11-29.

Condition(s): Healthy Volunteers

Source: https://euclinicaltrials.eu/ctis-public/view/2023-507753-15-00